EU clinical trial 2024-510790-19-00: Randomized, double-blind, placebo-controlled trial of the efficacy and safety of tianeptine in the treatment of covid fog symptoms in patients after COVID-19 with the study of the pathophysiology of the phenomenon using positron emission tomography, biochemical, immunological and electrophysiological parameters (COVMENT).
Protocol code: ABM/COVMENT/2021
Sponsor: Wojskowy Instytut Medyczny Panstwowy Instytut Badawczy (Hospital/Clinic/Other health care facility). Phase: Therapeutic exploratory (Phase II). Countries: Poland (ongoing, recruiting).
Therapeutic area(s): Diseases [C] - Nervous System Diseases [C10]
Gender: Female, Male. Age: 18-64 years, 65+ years. Enrolment: 140.
Status: Ongoing, recruiting. Start date (EU): 2024-12-02. Decision date: 2024-12-02. Results received: No. Last updated: 2024-12-02.

Condition(s): Covid fog - a dysfunctional condition characterized by slowed thinking, disorientation, difficulty remembering, impaired attention and concentration.
Product: Placebo, Tianesal, 12,5 mg, tabletki powlekane

Primary endpoint: Improvement in covid fog symptoms at week 16 after randomization defined as a 2 point improvement in MoCA score.
Endpoint(s): Complete resolution of covid fog symptoms at week 16 after randomization defined as normalization of MoCA scale score (MoCA = 26 - 30 points)., A 10% improvement in raw test scores covering various domains of cognitive functioning at week 16 after randomization: a) CTT, b) COWAT, c) SCWT, d) Repeating Digits from the WAIS-R, e) Digit symbols from WAIS-R., A 10% improvement in ECog-12 test raw scores at week 16 after randomization., Improvement in subjectively assessed depressive symptom severity defined as PHQ score < 5 points at week 16 after randomization., Improvement in subjectively assessed severity of anxiety symptoms defined as GAD-7 score<5 points at 16 weeks after randomization., Improvement in subjectively assessed severity of sleep difficulties defined as AIS score <6 points at 16 weeks after randomization., Improvement in subjectively assessed severity of loneliness defined as SLS score <5 points at 16 weeks after randomization., Reduction in severity or resolution of depressive symptoms as assessed by the MADRS scale. Resolution of symptoms will be defined as a MADRS score < 9 points.

Source: https://euclinicaltrials.eu/ctis-public/view/2024-510790-19-00